EU clinical trial 2023-506230-71-01: Vaccination in patients with inflammatory rheumatic diseases. The impact of anti-rheumatic treatments on the immunogenicity of herpes-zoster vaccine (Shingrix) and protection against infection (HZ-REUMA)
Protocol code: HZ_REUMA
Sponsor: Region Skane Skanes Universitetssjukhus (Hospital/Clinic/Other health care facility). Phase: Therapeutic use (Phase IV). Countries: Sweden (ongoing, recruiting).
Therapeutic area(s): Diseases [C] - Virus Diseases [C02]; Diseases [C] - Musculoskeletal Diseases [C05]
Gender: Female, Male. Age: 18-64 years, 65+ years. Enrolment: 1.
Status: Ongoing, recruiting. Start date (EU): 2024-12-17. Decision date: 2023-11-06. Results received: No. Last updated: 2023-11-06.

Condition(s): inflammatory rheumatic diseases (IRD): rheumatoid arthritis (RA), SLE, spondylarthropathies, psoriatic arthritis, systemic vasculitis or systemic sclerosis, vaccination

Source: https://euclinicaltrials.eu/ctis-public/view/2023-506230-71-01